EU clinical trial 2025-523832-38-00: Multicenter Interventional Study Somatrogon Impact on Outcomes in Naive Small for Gestational Age or Idiopathic Short Stature paediatric patients compared with daily growth hormone
Protocol code: RCRC000035
Sponsor: Schneider Children's Medical Center Of Israel (Hospital/Clinic/Other health care facility). Phase: Therapeutic confirmatory (Phase III). Countries: Greece (authorised, recruitment pending), Poland (authorised, recruitment pending), France (authorised, recruitment pending), Czechia (authorised, recruitment pending).
Therapeutic area(s): Diseases [C] - Musculoskeletal Diseases [C05]
Gender: Female, Male. Age: 0-17 years. Enrolment: 95.
Status: Authorised, recruitment pending. Decision date: 2026-06-23. Results received: No. Last updated: 2026-07-15.
Decision dates by country: CZ: 2026-06-24, FR: 2026-06-29, GR: 2026-06-23, PL: 2026-06-26

Condition(s): Small for gestational age (SGA) and idiopathic short stature (ISS)
Product: Ngenla 60 mg solution for injection in pre-filled pen, GENOTROPIN 12 mg powder and solvent for solution for injection.

Primary endpoint: Annualized HV after 12 months of treatment

Source: https://euclinicaltrials.eu/ctis-public/view/2025-523832-38-00